EU clinical trial 2023-504017-79-00: A Phase 2a/2b Randomized, Placebo-Controlled Clinical Study to Evaluate the Safety and Efficacy of MK-1942 as Adjunctive Therapy in Participants with Mild to Moderate Alzheimer’s Disease Dementia
Protocol code: MK-1942-008
Sponsor: Merck Sharp & Dohme LLC (Pharmaceutical company). Phase: Therapeutic exploratory (Phase II). Countries: Italy (ended), Spain (ended).
Therapeutic area(s): Diseases [C] - Nervous System Diseases [C10]
Gender: Female, Male. Age: 18-64 years, 65+ years. Enrolment: 90.
Status: Ended. Start date (EU): 2023-02-14. End date (EU): 2023-08-10. Decision date: 2023-06-20. Results received: Yes. Last updated: 2023-07-26.
Decision dates by country: IT: 2023-07-26, ES: 2023-06-20

Condition(s): Treatment of AD dementia
Product: Placebo to mk-1942 - Capsule 0 mg

Primary endpoint: Change from baseline in the Alzheimer’s Disease Assessment Scale-11-item cognitive subscale (ADAS-Cog11) score at Week 12, Number of Participants Experiencing Adverse Events (AEs), Number of Participants Discontinuing Study Intervention Due to AEs
Endpoint(s): Alzheimer’s Disease Cooperative Study Clinical Global Impression of Change (ADCS-CGIC) Overall score at Week 12, Change from baseline in the Alzheimer’s Disease Cooperative Study Activities of Daily Living (ADCS-ADL) Total score at Week 12

Source: https://euclinicaltrials.eu/ctis-public/view/2023-504017-79-00